EU clinical trial 2024-512195-35-00: A Phase III, Randomised, Open-label, Global Study of Adjuvant Datopotamab Deruxtecan (Dato-DXd) in Combination With Rilvegostomig or Rilvegostomig Monotherapy Versus Standard of Care, Following Complete Tumour Resection, in Participants With Stage I Adenocarcinoma Non-small Cell Lung Cancer who are ctDNA-positive or Have High-risk Pathological Features (TROPION Lung12)
Protocol code: D926TC00001
Sponsor: AstraZeneca AB (Pharmaceutical company). Phase: Therapeutic confirmatory (Phase III). Countries: Netherlands (authorised, recruitment pending), Spain (authorised, recruitment pending), Hungary (authorised, recruitment pending), Germany (authorised, recruitment pending), France (authorised, recruitment pending), Italy (authorised, recruitment pending), Sweden (authorised, recruitment pending), Poland (authorised, recruitment pending), Belgium (authorised, recruitment pending).
Therapeutic area(s): Diseases [C] - Neoplasms [C04]
Gender: Female, Male. Age: 18-64 years, 65+ years. Enrolment: 119.
Status: Authorised, recruitment pending. Decision date: 2025-02-17. Results received: No. Last updated: 2025-12-03.
Decision dates by country: FR: 2025-02-19, ES: 2025-02-18, DE: 2025-02-19, BE: 2025-02-17, NL: 2025-02-17, SE: 2025-02-17, PL: 2025-02-24, HU: 2025-02-20, IT: 2025-02-18

Condition(s): Stage I adenocarcinoma non-small cell lung cancer (NSCLC) with ctDNA-positive result or high-risk pathological feature
Product: PEMETREXED, VINORELBINE, Rilvegostomig, MYCOPHENOLATE MOFETIL, ETOPOSIDE, CISPLATIN, INFLIXIMAB, CARBOPLATIN, Datopotamab deruxtecan

Primary endpoint: Disease-Free Survival (DFS) using BICR in participants with Stage I adenocarcinoma NSCLC who are ctDNA-positive or having at least one high-risk pathological feature treated with adjuvant Dato-DXd in combination with rilvegostomig relative to SoC
Endpoint(s): OS (Overall Survival): The analysis will include all randomised participants as randomised. All deaths will be included, regardless of whether the participant withdraws from therapy or receives another anti-cancer therapy. The measure of interest is the HR of OS., Participant-reported physical function: The analysis will include all randomised participants as randomised. The measure of interest will be the between treatment group difference in adjusted mean in physical function scores at Weeks 12, 24 and 48., Participant-reported GHS/QoL: The analysis will include all randomised participants as randomised. The measure of interest will be the between treatment group difference in adjusted mean in GHS/QoL scores at Weeks 12, 24 and 48., Pharmacokinetics (PK): Concentration of rilvegostomig, Dato-DXd, total anti‑TROP2 antibody, and MAAA‑1181a (payload deruxtecan) in serum or plasma and PK parameters (peak and trough concentrations)., Immunogenicity: Presence of ADAs for Dato-DXd and rilvegostomig (confirmatory results: titres and neutralizing antibodies for confirmed positive samples).

Source: https://euclinicaltrials.eu/ctis-public/view/2024-512195-35-00